EU clinical trial 2025-521558-40-00: A Phase 3, Randomized, Double-blind, Placebo-controlled, Multicenter, Parallelgroup Study to Evaluate the Efficacy and Safety of Treprostinil Palmitil Inhalation Powder in Participants with Pulmonary Hypertension Associated with Interstitial Lung Disease
Protocol code: INS1009-311
Sponsor: Insmed Inc. (Pharmaceutical company). Phase: Therapeutic confirmatory (Phase III). Countries: Portugal (ongoing, recruiting), Italy (ongoing, recruiting), Czechia (ongoing, recruiting), Poland (authorised, recruitment pending), Denmark (ongoing, recruiting), Greece (ongoing, recruiting), Germany (ongoing, recruiting), Romania (ongoing, recruiting), Spain (ongoing, recruiting), France (ongoing, recruiting), Belgium (ongoing, recruiting), Austria (authorised, recruitment pending).
Therapeutic area(s): Diseases [C] - Respiratory Tract Diseases [C08]
Gender: Female, Male. Age: 18-64 years, 65+ years. Enrolment: 251.
Start date (EU): 2026-02-12. Decision date: 2026-01-26. Results received: No. Last updated: 2026-03-30.
Decision dates by country: AT: 2026-01-26, BE: 2026-01-29, CZ: 2026-01-29, DK: 2026-01-27, FR: 2026-01-26, IT: 2026-01-28, PT: 2026-01-28, RO: 2026-02-02, ES: 2026-02-02, GR: 2026-01-27, PL: 2026-01-30, DE: 2026-01-28

Condition(s): Pulmonary Hypertension Associated with Interstitial Lung Disease
Product: Placebo (inhalation powder capsules) containing 1 of 4 dosage strengths of TPIP (80 μg, 160 μg, or 320 μg or 640 µg ), TREPROSTINIL PALMITIL INHALATION POWDER, TREPROSTINIL PALMITIL INHALATION POWDER, TREPROSTINIL PALMITIL INHALATION POWDER, TREPROSTINIL PALMITIL INHALATION POWDER

Primary endpoint: Change in 6MWD measured at peak exposure from Baseline to Week 24
Endpoint(s): Time from randomization to first clinical worsening over 24 weeks, Time from randomization to first major morbidity or mortality event over 24 weeks, Change in NT proBNP plasma concentration from Baseline over 24 weeks, Proportion of participants with improvement in NT proBNP levels over 24 weeks, Change in 6MWD measured at trough exposure from Baseline to Week 22, Change in 6MWD measured at peak exposure from Baseline over 20 weeks, Change in L-PF total symptom domain score from Baseline over 24 weeks, Mean Change From Baseline in Living With Pulmonary Fibrosis (L-PF) Total Symptom Domain Score Over 24 Week, Plasma Concentrations of Treprostinil Palmitil (TP) and Treprostinil (TRE)

Source: https://euclinicaltrials.eu/ctis-public/view/2025-521558-40-00